EU clinical trial 2024-516394-78-00: LOVIT-ARDS - A Multicentre Concealed‐Allocation Parallel‐Group Blinded Randomized Controlled Trial to Ascertain the Effect of High‐Dose Intravenous Vitamin C Compared to Placebo on Mortality or Persistent Organ Dysfunction at 28 Days in Septic ARDS Patients
Protocol code: APHP200019
Sponsor: Assistance Publique Hopitaux De Paris (Hospital/Clinic/Other health care facility). Phase: Therapeutic confirmatory (Phase III). Countries: France (authorised, recruiting).
Therapeutic area(s): Diseases [C] - Bacterial Infections and Mycoses [C01]; Diseases [C] - Respiratory Tract Diseases [C08]
Gender: Female, Male. Age: 18-64 years, 65+ years. Enrolment: 814.
Status: Authorised, recruiting. Start date (EU): 2024-11-05. Decision date: 2024-11-05. Results received: No. Last updated: 2026-06-22.

Condition(s): Patient with sepsis complicated by ARDS
Product: SODIUM CHLORIDE, Biological Therapies Sodium Ascorbate Solution 30 g in 100 mL Injection

Primary endpoint: Death or persistent organ dysfunction (defined as continued dependency on mechanical ventilation, renal replacement therapy, or vasopressors) at 28 days

Source: https://euclinicaltrials.eu/ctis-public/view/2024-516394-78-00